EU clinical trial 2024-518807-23-00: Comparing postoperative recovery after vitrectomy using NSAID eyedrops versus steroid eyedrops
Sponsor: UZ Leuven (Hospital/Clinic/Other health care facility). Phase: Therapeutic use (Phase IV). Countries: Belgium (ongoing, recruiting).
Therapeutic area(s): Diseases [C] - Eye Diseases [C11]
Gender: Female, Male. Age: 18-64 years, 65+ years. Enrolment: 120.
Status: Ongoing, recruiting. Start date (EU): 2025-09-01. Decision date: 2025-07-08. Results received: No. Last updated: 2025-07-08.

Condition(s): Macular hole, Vitreomacular traction syndrome, Macular pucker
Product: Monofree Dexamethason 1 mg/ml, oogdruppels, oplossing in verpakking voor éénmalig gebruik, Dicloabak 1 mg/ml oogdruppels, oplossing, Volon A 40, Kristallsuspension

Primary endpoint: Incidence of an increase of at least 10 mmHg in IOP compared to baseline measured at week 2 and week 8.
Endpoint(s): Amount and grading of macular oedema on OCT at month 2 and 6 after surgery: - Presence or absence of intra-retinal cysts - Ratio of (Pre-op subfoveal thickness – Post-op thickness) / Pre-op thickness, Amount of intra-ocular inflammation measured using laser flare photometry at day 3 (+/_ 2 days), week 2 and week 8.

Source: https://euclinicaltrials.eu/ctis-public/view/2024-518807-23-00